EU clinical trial 2023-507460-39-00: A phase 2 trial in stage II-IIIa urothelial cancer randomizing pre-operative nivolumab with or without relatlimab - TURANDORELA
Sponsor: Het Nederlands Kanker Instituut-Antoni van Leeuwenhoek Ziekenhuis Stichting (Hospital/Clinic/Other health care facility). Phase: Phase II and Phase III (Integrated). Countries: Netherlands (ongoing, recruitment ended).
Therapeutic area(s): Diseases [C] - Neoplasms [C04]
Gender: Female, Male. Age: 18-64 years, 65+ years. Enrolment: 90.
Status: Ongoing, recruitment ended. Start date (EU): 2024-02-15. Decision date: 2024-01-15. Results received: No. Last updated: 2025-05-07.

Condition(s): Adult patients with resectable muscle-invasive urothelial cancer of the bladder, defined as stage II and IIIa UC, who have not yet undergone systemic therapy for UBC.
Product: OPDIVO 10 mg/mL concentrate for solution for infusion., Relatlimab intravenous

Primary endpoint: Pathological complete response (pCR), defined as pT0N0 or pTisN0, at cystectomy
Endpoint(s): Percentage of patients that completes cystectomy within 12 weeks of start of treatment. Patients who elect to not undergo surgery or have a delay due to logistical reasons not related to study treatment will be excluded from this analysis., Overall Survival. Event-Free Survival; events are defined as: - Disease progression precluding surgery - Disease recurrence outside the urinary tract (distant metastases, pelvic recurrence) - Muscle invasive recurrence in the bladder or distal ureters - Switch to other treatments directed at systemic urothelial cancer, Immune-related adverse events (irAE) according to CTCAE 5.0 criteria

Source: https://euclinicaltrials.eu/ctis-public/view/2023-507460-39-00